EU clinical trial 2024-513538-40-02: Positron emission tomography with macrophage targeting to select individuals at risk for rheumatoid arthritis.
Sponsor: Amsterdam UMC Stichting, ZonMw (Hospital/Clinic/Other health care facility, Health care). Phase: Therapeutic exploratory (Phase II). Countries: Netherlands (ongoing, recruiting).
Therapeutic area(s): Diseases [C] - Musculoskeletal Diseases [C05]; Analytical, Diagnostic and Therapeutic Techniques and Equipment [E] - Investigative Techniques [E05]; Diseases [C] - Immune System Diseases [C20]
Gender: Female, Male. Age: 18-64 years, 65+ years. Enrolment: 60.
Status: Ongoing, recruiting. Start date (EU): 2024-12-09. Decision date: 2024-12-09. Results received: No. Last updated: 2024-12-09.

Condition(s): ACPA positive arthralgia
Product: [18F]Fluor-PEG-Folate

Primary endpoint: Sensitivity, Specificity, Positive predictive value, Negative predictive value
Endpoint(s): Relationship of PET positivity and time to development of clinical arthritis., Cut-off value(s) for this/these specific outcome measure(s) in relation todevelopment of RA within one year.

Source: https://euclinicaltrials.eu/ctis-public/view/2024-513538-40-02